EU clinical trial 2025-522541-21-00: A Phase 1 Study to Assess Radiation Biodistribution, Dosimetry, Pharmacokinetics and Safety of GEH300079 (68Ga) Injection and Determine the Optimal Injected Activity and Timing of PET/CT Imaging in Patients with Peritoneal Carcinomatosis of Colorectal, Gastric, Pancreatic or Ovarian Origin
Protocol code: GE-282-101
Sponsor: GE Healthcare Limited (Pharmaceutical company). Phase: Human Pharmacology (Phase I)- Other. Countries: Sweden (ongoing, recruiting).
Therapeutic area(s): Diseases [C] - Neoplasms [C04]
Gender: Female, Male. Age: 18-64 years, 65+ years. Enrolment: 16.
Status: Ongoing, recruiting. Start date (EU): 2026-04-28. Decision date: 2026-02-24. Results received: No. Last updated: 2026-02-24.

Condition(s): Peritoneal Carcinomatosis of Colorectal,Gastric, Pancreatic or Ovarian Origin

Source: https://euclinicaltrials.eu/ctis-public/view/2025-522541-21-00